EU clinical trial 2023-507175-22-00: I3Y-MC-JPCG: A Randomized, Open-Label, Phase 2 Study of Abemaciclib Plus Tamoxifen or Abemaciclib Alone, in Women With Previously Treated Hormone Receptor-Positive, HER2-Negative, Metastatic Breast Cancer
Protocol code: I3Y-MC-JPCG
Sponsor: Eli Lilly & Co. (Pharmaceutical company). Phase: Therapeutic exploratory (Phase II). Countries: Italy (ongoing, recruitment ended).
Therapeutic area(s): Diseases [C] - Neoplasms [C04]
Gender: Female. Age: 18-64 years, 65+ years. Enrolment: 1.
Status: Ongoing, recruitment ended. Start date (EU): 2016-09-19. Decision date: 2024-08-06. Results received: No. Last updated: 2026-04-02.

Condition(s): Metastatic Breast Cancer
Product: Verzenios 50 mg film-coated tablets, TAMOXIFEN

Primary endpoint: Progression Free Survival (PFS) [ Time Frame: Baseline to Objective Disease Progression or Death from Any Cause (Up to 21 Months) ]
Endpoint(s): Objective Response Rate (ORR): Percentage of Participants With a Complete Response (CR) or Partial Response (PR) [ Time Frame: Baseline to Objective Disease Progression (Up to 21 Months) ]

Source: https://euclinicaltrials.eu/ctis-public/view/2023-507175-22-00